EU clinical trial 2024-518213-25-00: A Phase 2b/Phase 3, randomized, double-blind, placebo-controlled, multicenter study, to investigate the efficacy and safety of lunsekimig in adult participants with inadequately controlled chronic obstructive pulmonary disease (COPD) characterized by an eosinophilic phenotype
Protocol code: EFC18244-THESEUS
Sponsor: Sanofi-Aventis Recherche & Developpement (Pharmaceutical company). Phase: Phase II and Phase III (Integrated). Countries: Germany (ongoing, recruiting), Romania (authorised, recruitment pending), Greece (authorised, recruitment pending), Norway (authorised, recruitment pending), Netherlands (authorised, recruitment pending), Poland (ongoing, recruiting), Lithuania (ongoing, recruiting), Czechia (ongoing, recruiting), Slovakia (ongoing, recruiting), Spain (ongoing, recruiting).
Therapeutic area(s): Diseases [C] - Respiratory Tract Diseases [C08]
Gender: Female, Male. Age: 18-64 years, 65+ years. Enrolment: 550.
Start date (EU): 2026-07-15. Decision date: 2026-07-06. Results received: No. Last updated: 2026-07-13.
Decision dates by country: CZ: 2026-07-07, DE: 2026-07-10, GR: 2026-07-07, LT: 2026-07-07, RO: 2026-07-13, ES: 2026-07-10, NL: 2026-07-08, NO: 2026-07-13, PL: 2026-07-06, SK: 2026-07-06

Condition(s): Respiratory tract diseases
Product: LUNSEKIMIG, Matched Placebo for Test

Primary endpoint: Annualized rate of moderate to severe chronic obstructive pulmonary disease (COPD) exacerbations
Endpoint(s): Change from baseline in post-Bronchodilator Forced Expiratory Volume in 1 second (post-BD FEV1), Change from baseline in pre-Bronchodilator Forced Expiratory Volume in 1 second (pre-BD FEV1), Change from baseline in the SGRQ-C total score, SGRQ responder defined as an improvement of ≥4 points in the SGRQ-C total score, Change from baseline in the Chronic airways assessment Test (CAAT) score, CAAT responder defined as an improvement of ≥2 points in the CAAT) total score, Change from baseline in the E-RS:COPD total score, E-RS:COPD responder defined as an improvement of ≥2 points in the E RS:COPD total score, Annualized rate of severe COPD exacerbations, Time to first moderate or severe COPD exacerbation, Time to first severe COPD exacerbation, Incidence of participants with TEAEs, including AESIs, and SAEs, Incidence of potentially clinically significant laboratory abnormalities, Serum concentration of lunsekimig, Incidence and titer of antidrug antibodies (ADAs)

Source: https://euclinicaltrials.eu/ctis-public/view/2024-518213-25-00